EU clinical trial 2024-511956-42-00: A Phase IB Study to determine efficacy and safety of Durvalumab and/or novel anti-cancer agents, with or without chemotherapy, in patients with previously untreated NSCLC
Protocol code: D933IC00001
Sponsor: AstraZeneca AB (Pharmaceutical company). Phase: Human Pharmacology (Phase I)- Other. Countries: Poland (ended).
Therapeutic area(s): Diseases [C] - Neoplasms [C04]
Gender: Female, Male. Age: 18-64 years, 65+ years. Enrolment: 44.
Status: Ended. Start date (EU): 2019-05-14. End date (EU): 2026-02-10. Decision date: 2024-06-03. Results received: No. Last updated: 2026-05-11.

Condition(s): Metastatic Non-Small Cell Lung Cancer (NSCLC)

Source: https://euclinicaltrials.eu/ctis-public/view/2024-511956-42-00